EU clinical trial 2024-516572-15-00: Low molecular weight heparin in the treatment of early fetal growth restriction – a Randomized Controlled Trial
Protocol code: 1375_RCF_MAC
Sponsor: Unidade Local De Saude De Sao Jose E.P.E. (Hospital/Clinic/Other health care facility). Phase: Therapeutic use (Phase IV). Countries: Portugal (ongoing, recruiting).
Therapeutic area(s): Diseases [C] - Female Urogenital Diseases and Pregnancy Complications [C13]
Gender: Female. Age: 18-64 years. Enrolment: 160.
Status: Ongoing, recruiting. Start date (EU): 2024-09-16. Decision date: 2024-09-16. Results received: No. Last updated: 2024-09-16.

Condition(s): Fetal Growth Restriction
Product: Enoxaparina Rovi 4.000 UI (40 mg)/0,4 mL solução injetável em seringa pré-cheia

Primary endpoint: Gestational age at delivery
Endpoint(s): Evolution of fetal Doppler parameters (umbilical artery pulsatility index, middle cerebral artery pulsatility index, cerebralplacental ratio, ductus venosus pulsatility index), Evolution of maternal doppler parameters (uterine artery pulsatility index), Maternal body mass index (BMI) at moment of randomization, Newborn weight, percentile, umbilical artery pH and Apgar score in the 5th minute, Neonatal intensive care admission and duration of admission, A composite outcome of severe neonatal morbidity (evidence of one or more of: intraventricular hemorrhage grade 3 or 4; cystic periventricular leukomalacia; chronic lung disease; retinopathy of prematurity requiring treatment; necrotizing enterocolitis requiring surgery), Gestational hypertension or preeclampsia, Placental abruption, Antepartum hemorrhage, Maternal thrombocytopenia (platelets < 100 000 x 109/L), Stillbirth, Mode of delivery, Indication for delivery, Postpartum hemorrhage, Placental pathology, sFLT1-PLGF ratio, Syncytiotrophoblast derived vesicles (STD-EVS)

Source: https://euclinicaltrials.eu/ctis-public/view/2024-516572-15-00